EU clinical trial 2022-500540-38-00: A study to investigate the safety and tolerability of intravenous QEQ278 in patients with advanced solid tumors
Protocol code: CQEQ278A12101
Sponsor: Novartis Pharma AG (Pharmaceutical company). Phase: Human Pharmacology (Phase I)- First administration to humans. Countries: France (ended), Italy (ended), Germany (ended), Belgium (ended), Spain (ended).
Therapeutic area(s): Diseases [C] - Neoplasms [C04]
Gender: Female, Male. Age: 18-64 years, 65+ years. Enrolment: 88.
Status: Ended. Start date (EU): 2023-06-27. End date (EU): 2025-01-22. End date: 2026-01-26. Decision date: 2022-12-06. Results received: No. Last updated: 2024-12-10.
Decision dates by country: ES: 2022-12-12, BE: 2022-12-07, IT: 2022-12-07, DE: 2022-12-08, FR: 2022-12-06

Condition(s): Non-small cell lung cancer; Oesophageal squamous cell carcinoma; Renal cell carcinoma; Squamous cell carcinoma of head and neck

Source: https://euclinicaltrials.eu/ctis-public/view/2022-500540-38-00